EU clinical trial 2024-518677-34-00: A randomized controlled trial using indocianine green during cholecystectomy in acute cholecystitis.
Protocol code: INDURGTRIAL2022
Sponsor: Fundacio Parc Tauli (Patient organisation/association). Phase: Therapeutic use (Phase IV). Countries: Spain (ongoing, recruiting).
Therapeutic area(s): Phenomena and Processes [G] - Digestive System and Oral Physiological Phenomena [G10]
Gender: Female, Male. Age: 18-64 years, 65+ years. Enrolment: 440.
Status: Ongoing, recruiting. Start date (EU): 2023-03-15. Decision date: 2024-11-04. Results received: No. Last updated: 2024-11-04.

Condition(s): Emergency cholecystectomy is the gold standard treatment for acute cholecystitis. The procedure is feasible but carries a higher risk of iatrogenic injury to the bile duct, which should be considered preventable. Intraoperative fluorescence cholangiography following injection of indocyanine green (ICG) has been reported to aid identification of the extrahepatic bile duct.
Product: INDOCYANINE GREEN

Primary endpoint: Surgical time (minutes): It is defined as the time between the first incision in the skin until its closure.

Source: https://euclinicaltrials.eu/ctis-public/view/2024-518677-34-00